EU clinical trial 2025-520506-35-00: A Phase 2, Single Arm, Multicenter Study to Evaluate the Pharmacodynamics and Safety of Re-Treatment with ALXN2220 in Patients with Transthyretin Amyloid Cardiomyopathy
Protocol code: NI006-102
Sponsor: Neurimmune AG (Pharmaceutical company). Phase: Therapeutic exploratory (Phase II). Countries: Netherlands (ongoing, recruitment ended), Spain (ongoing, recruitment ended), Germany (ongoing, recruitment ended), France (ongoing, recruitment ended).
Therapeutic area(s): Diseases [C] - Cardiovascular Diseases [C14]
Gender: Female, Male. Age: 18-64 years, 65+ years. Enrolment: 35.
Status: Ongoing, recruitment ended. Start date (EU): 2025-06-30. Decision date: 2025-06-24. Results received: No. Last updated: 2026-05-13.
Decision dates by country: NL: 2025-06-24, ES: 2025-06-24, DE: 2025-06-26, FR: 2025-06-27

Condition(s): Adults with Transthyretin Amyloid Cardiomyopathy (ATTR-CM)
Product: Recombinant human anti-ATTR immunoglobulin G1 (IgG1) monoclonal antibody (mAb)

Primary endpoint: Change from baseline to Visit 16 in cMRI, Change from baseline to Visit 16 in scintigraphy
Endpoint(s): Incidence of TEAEs, including serious TEAEs, Change from baseline by visit for vital signs and physical examination, Change from baseline by visit in clinical laboratory parameters, Change from baseline by visit for ECG parameters, ALXN2220 serum concentrations, ADA incidence, response category and titer

Source: https://euclinicaltrials.eu/ctis-public/view/2025-520506-35-00